EU clinical trial 2023-504998-20-00: A Phase III Double-Blind, Randomised, Placebo-Controlled Study Assessing the Efficacy and Safety of Capivasertib + Abiraterone Versus Placebo + Abiraterone as Treatment for Patients with De Novo Metastatic Hormone-Sensitive Prostate Cancer (mHSPC) Characterised by PTEN deficiency (CAPItello-281)
Protocol code: D361BC00001
Sponsor: AstraZeneca AB (Pharmaceutical company). Phase: Therapeutic confirmatory (Phase III). Countries: Spain (ongoing, recruitment ended), Slovakia (ongoing, recruitment ended), Poland (ongoing, recruitment ended), Belgium (ongoing, recruitment ended), Czechia (ongoing, recruitment ended), Netherlands (ongoing, recruitment ended), France (ongoing, recruitment ended), Bulgaria (ongoing, recruitment ended), Germany (ongoing, recruitment ended).
Therapeutic area(s): Phenomena and Processes [G] - Reproductive and Urinary Physiological Phenomena [G08]; Phenomena and Processes [G] - Musculoskeletal and Neural Physiological Phenomena [G11]; Phenomena and Processes [G] - Digestive System and Oral Physiological Phenomena [G10]; Phenomena and Processes [G] - Physiological processes [G07]; Phenomena and Processes [G] - Circulatory and Respiratory Physiological Phenomena [G09]; Phenomena and Processes [G] - Microbiological Phenomena [G06]; Phenomena and Processes [G] - Genetic Phenomena [G05]; Phenomena and Processes [G] - Cell Physiological Phenomena [G04]
Gender: Male. Age: 18-64 years, 65+ years. Enrolment: 271.
Status: Ongoing, recruitment ended. Start date (EU): 2020-09-18. Decision date: 2024-06-21. Results received: No. Last updated: 2026-05-25.
Decision dates by country: FR: 2024-06-25, ES: 2024-06-24, CZ: 2024-06-26, BE: 2024-06-21, BG: 2024-07-01, SK: 2024-06-24, NL: 2024-06-24, DE: 2024-06-24, PL: 2024-06-24

Condition(s): Metastatic Hormone-sensitive Prostate Cancer Characterised by PTEN deficiency
Product: Capivasertib, Capivasertib, Placebo for capivasertib film-coated tablet for oral use, ABIRATERONE ACETATE

Primary endpoint: 1.Radiographic Progression-free Survival (rPFS) in patients with PTENdeficient Per Response Evaluation Criteria in Solid Tumors Version 1.1(RECIST 1.1) for soft tissue and/or Prostate Cancer Working Group 3(PCWG3) for bone as Assessed by the Investigator
Endpoint(s): 1.To compare the effect of capivasertib+abiraterone relative to placebo+abiraterone by assessment of overall survival 2.To compare the effect of capivasertib+abiraterone relative to placebo+abiraterone by assessment of time to start of first subsequent therapy or death (TFST), 3.To compare the effect of capivasertib+abiraterone relative to placebo+abiraterone by assessment of time to start symptomatic skeletal event-free survival (SSE-FS) 4.To compare the effect of capivasertib+abiraterone relative to placebo+abiraterone by assessment of time to pain progression (TTPP), 5.To evaluate the PK of capivasertib in combination with abiraterone 6.To evaluate safety and tolerability assessment of capivasertib+abiraterone as compared to placebo+abiraterone in patients with PTEN-deficient mHSPC

Source: https://euclinicaltrials.eu/ctis-public/view/2023-504998-20-00